EU clinical trial 2023-509132-26-00: A study to investigate safety of INT2104 infusions in participants aged 18 years of age and older who have B-cell cancers that came back after previous treatment [INVISE]
Protocol code: INT2104-101
Sponsor: Interius Biotherapeutics Inc. (Pharmaceutical company). Phase: Human Pharmacology (Phase I)- First administration to humans. Countries: Spain (ended), Germany (ended).
Therapeutic area(s): Diseases [C] - Neoplasms [C04]
Gender: Female, Male. Age: 18-64 years, 65+ years. Enrolment: 16.
Status: Ended. Start date (EU): 2025-08-08. End date (EU): 2026-03-18. Decision date: 2024-12-12. Results received: No. Last updated: 2026-03-24.
Decision dates by country: DE: 2024-12-12, ES: 2024-12-16

Condition(s): Refractory/Relapsing B-Cell Malignancies

Source: https://euclinicaltrials.eu/ctis-public/view/2023-509132-26-00